EU clinical trial 2023-509632-26-00: A Phase 1b/2 pan-tumor, open-label study to evaluate the efficacy and safety of ifinatamab deruxtecan (I DXd) in subjects with recurrent or metastatic solid tumors
Protocol code: DS7300-203
Sponsor: Daiichi Sankyo Inc. (Pharmaceutical company). Phase: Phase I and Phase II (Integrated)- Other. Countries: Italy (ongoing, recruiting), France (ongoing, recruiting), Poland (ongoing, recruiting), Germany (ongoing, recruiting), Spain (ongoing, recruiting), Belgium (ongoing, recruiting), Ireland (ongoing, recruiting), Portugal (ongoing, recruiting), Netherlands (ongoing, recruiting).
Therapeutic area(s): Diseases [C] - Neoplasms [C04]
Gender: Female, Male. Age: 18-64 years, 65+ years. Enrolment: 311.
Status: Ongoing, recruiting. Start date (EU): 2025-02-11. Decision date: 2024-12-02. Results received: No. Last updated: 2026-06-04.
Decision dates by country: FR: 2024-12-06, BE: 2024-12-02, PT: 2024-12-06, IT: 2024-12-04, DE: 2024-12-05, IE: 2024-12-06, NL: 2024-12-03, PL: 2024-12-09, ES: 2024-12-05

Condition(s): Recurrent or Metastatic Solid Tumors (endometrial cancer (EC); head and neck squamous cell carcinoma (HNSCC); pancreatic ductal adenocarcinoma (PDAC); colorectal cancer (CRC); hepatocellular carcinoma (HCC); adenocarcinoma of esophagus, gastroesophageal junction, and stomach (Ad-Eso/GEJ/gastric); urothelial carcinoma (UC); ovarian cancer (OVC); cervical cancer (CC); biliary tract cancer (BTC); human epidermal growth factor 2 (HER2)-low breast cancer (BC); HER2 immunohistochemistry (IHC) 0 BC; and cutaneous melanoma)
Product: Ifinatamab deruxtecan

Primary endpoint: ORR is defined as the percentage of subjects with a BOR of confirmed CR or confirmed PR as assessed by the investigator per RECIST v1.1., DLTs and TEAEs graded according to the NCI-CTCAE v5.0, including deaths and other relevant safety endpoints.
Endpoint(s): Incidence of TEAEs, SAEs, and AESIs graded according to the NCI-CTCAE v5.0, including deaths, changes from baseline in vital signs, clinical laboratory results, ECGs, ECHO/MUGA, ophthalmologic findings, and other relevant safety endpoints., DoR is defined as the time from the date of the first documentation of objective tumor response (CR or PR), subsequently confirmed by investigator assessment, to the first documentation of objective tumor progression (confirmed by investigator assessment) or to death from any cause, whichever occurs first., PFS is defined as the time interval from the date of the first dose of study drug to the date of disease progression as assessed by the investigator per RECIST v1.1 or death from any cause., OS is defined as the time interval from the date of the first dose of study drug to the date of death from any cause., DCR is defined as the percentage of subjects with a BOR of confirmed CR, confirmed PR, or SD as assessed by the investigator per RECIST v1.1., Plasma PK parameters (eg, Tmax, t1/2, Cmax, Ctrough, AUC) for I-DXd, total anti-B7-H3 antibody, and DXd., ADA as measured in the plasma via a validated assay. ADA prevalence: defined as the proportion of subjects who are ADA positive at any point in time (including pre-existing ADA at baseline and treatment-emergent ADA). ADA incidence: defined as the proportion of subjects having treatment-emergent ADA. Titer and neutralizing antibodies will be determined when the ADA is positive.

Source: https://euclinicaltrials.eu/ctis-public/view/2023-509632-26-00